EU clinical trial 2024-516023-13-00: A Phase 3, Randomized, Placebo-Controlled, Double-Blind Study to Evaluate the Efficacy and Safety of Risankizumab Subcutaneous Induction Treatment in Subjects with Moderately to Severely Active Crohn’s Disease
Protocol code: M23-784
Sponsor: AbbVie Deutschland GmbH & Co. KG (Pharmaceutical company). Phase: Therapeutic confirmatory (Phase III). Countries: Lithuania (ongoing, recruitment ended), Czechia (ongoing, recruitment ended), Hungary (ongoing, recruitment ended), Poland (ongoing, recruitment ended).
Therapeutic area(s): Diseases [C] - Immune System Diseases [C20]
Gender: Female, Male. Age: 18-64 years, 65+ years. Enrolment: 31.
Status: Ongoing, recruitment ended. Start date (EU): 2025-01-23. Decision date: 2024-11-28. Results received: No. Last updated: 2026-07-22.
Decision dates by country: HU: 2025-04-23, PL: 2025-04-24, CZ: 2025-04-22, LT: 2024-11-28

Condition(s): Crohn's disease
Product: Placebo for risankizumab, ABBV-066

Primary endpoint: Achievement of CDAI clinical remission (defined as CDAI < 150) at Week 12, Achievement of endoscopic response (defined as decrease in SES-CD > 50% from baseline or for subjects with isolated ileal disease and a baseline SES-CD of 4, at least a 2-point reduction from baseline, as scored by blinded central reviewer) at Week 12
Endpoint(s): Achievement of SF/APS Clinical remission (defined as average daily SF ≤ 2.8 and not worse than Baseline AND average daily AP score ≤ 1 and not worse than Baseline) at Week 12, Achievement of endoscopic remission (defined as SES-CD ≤ 4 and at least a 2-point reduction versus Baseline and no subscore greater than 1 in any individual variable, as scored by a blinded central reviewer) at Week 12, Achievement of ulcer-free endoscopy (defined as SES-CD ulcerated surface subscore of 0 in subjects with SESCD ulcerated surface subscore ≥ 1 at Baseline, as scored by a blinded central reviewer) at Week 12, Change from Baseline in FACIT-Fatigue at Week 12, Achievement of CR-100 CDAI clinical response (defined as at least a 100-point reduction from Baseline in CDAI) at Week 4

Source: https://euclinicaltrials.eu/ctis-public/view/2024-516023-13-00